EU clinical trial 2024-517582-16-00: Best hypnotic drug choice for rapid sequence induction in the operating room: a 3-arm randomized trial open-labelled with blinded evaluation of the primary outcome
Protocol code: RC24_0389
Sponsor: Centre Hospitalier Universitaire De Nantes (Hospital/Clinic/Other health care facility). Phase: Therapeutic confirmatory (Phase III). Countries: France (ongoing, recruiting).
Therapeutic area(s): Analytical, Diagnostic and Therapeutic Techniques and Equipment [E] - Anesthesia and Analgesia [E03]
Gender: Female, Male. Age: 18-64 years, 65+ years. Enrolment: 1218.
Status: Ongoing, recruiting. Start date (EU): 2025-04-14. Decision date: 2025-03-14. Results received: No. Last updated: 2025-10-21.

Condition(s): rapid sequence induction in the operating room
Product: PROPOFOL, KETAMINE

Primary endpoint: The composite primary outcome is the proportion of patients with successful intubation at first attempt and without post-induction hypotension defined by a mean arterial pressure ≤ 60 mmHg within 10 minutes after the start of the hypnotic injection.
Endpoint(s): compared between the three study groups : Components of the primary outcomes analyzed separately: 1/rates of arterial hypotension episodes as defined in primary endpoint within 10 minutes after induction of anaesthesia 2/rates of tracheal intubation at the first attempt, Related to secondary Aim (1). Efficacy of ketamine and / or ketamine-propofol combination compared to standard doses of propofol on the prevention of postoperative complications: In the operating theatre (within 10 minutes after the start of the hypnotic injection): intubation quality score (IDS-3) values, Cormack-Lehane score values and POGO score values, Related to secondary Aim (1). Efficacy of ketamine and / or ketamine-propofol combination compared to standard doses of propofol on the prevention of postoperative complications: In the operating theatre (within 10 minutes after the start of the hypnotic injection): time between administration of hypnotic (start of anesthetic induction) and tracheal intubation (defined as the 6th capnography curve), Related to secondary Aim (1). Efficacy of ketamine and / or ketamine-propofol combination compared to standard doses of propofol on the prevention of postoperative complications: In the operating theatre (within 10 minutes after the start of the hypnotic injection): values of heart rate, SpO2 and systolic/diastolic/mean arterial pressure measuredevery 1 minute from pre-oxygenation to 10 minutes after the start of the hypnotic injection, Related to secondary Aim (1). Efficacy of ketamine and / or ketamine-propofol combination compared to standard doses of propofol on the prevention of postoperative complications: In the operating theatre (within 10 minutes after the start of the hypnotic injection): rates of pulmonary aspiration of gastric contents during the intubation procedure, Related to secondary Aim (1). Efficacy of ketamine and / or ketamine-propofol combination compared to standard doses of propofol on the prevention of postoperative complications: In the operating theatre (within 10 minutes after the start of the hypnotic injection): minimal value of SpO2 value during the 10 first minutes after anaesthesia induction, Related to secondary Aim (1). Efficacy of ketamine and / or ketamine-propofol combination compared to standard doses of propofol on the prevention of postoperative complications: In the operating theatre (within 10 minutes after the start of the hypnotic injection): rates of vasopressor use and volume of intravenous fluids for vascular filling (from entry into the operating theatre to induction and from induction to recovery room), Related to secondary Aim (2). Tolerance of ketamine and / or ketamine-propofol combination compared to standard doses of propofol: In the recovery room: postoperative Nu-DESC score value compared with preoperative score, Related to secondary Aim (2). Tolerance of ketamine and / or ketamine-propofol combination compared to standard doses of propofol: In the recovery room: need of sedative therapy in the recovery room to treat a delirium episode., Related to secondary Aim (2). Tolerance of ketamine and / or ketamine-propofol combination compared to standard doses of propofol: Up to day 7: rates of major cardiovascular complications defined as: cardiac arrest, sustained arrhythmia, myocardial infarction, stroke (total, ischaemic, and haemorrhagic), coronary revascularization or admission to ICU for acute heart failure, Related to secondary Aim (2). Tolerance of ketamine and / or ketamine-propofol combination compared to standard doses of propofol: Up to day 7: rates of mortality at day 7, Related to secondary Aim (1). Efficacy of ketamine and / or ketamine-propofol combination compared to standard doses of propofol on the prevention of postoperative complications: In the operating theatre (within 10 minutes after the start of the hypnotic injection): - rates of failure of tracheal intubation after the first attempt, Related to secondary Aim (1). Efficacy of ketamine and / or ketamine-propofol combination compared to standard doses of propofol on the prevention of postoperative complications: In the operating theatre (within 10 minutes after the start of the hypnotic injection):Use of ketamine and total dose during intervention and total dose of ketamine in recovery room.

Source: https://euclinicaltrials.eu/ctis-public/view/2024-517582-16-00